EU clinical trial 2025-521470-34-00: A phase 3 randomized, placebo-controlled, triple blind parallel-group study of candesartan in adults with episodic cluster headache (Episodic CandClus2)
Protocol code: E. CandClus2 V3
Sponsor: Helse Bergen HF, St. Olavs Hospital HF (Hospital/Clinic/Other health care facility). Phase: Therapeutic confirmatory (Phase III). Countries: Denmark (authorised, recruitment pending), Norway (authorised, recruitment pending).
Therapeutic area(s): Diseases [C] - Nervous System Diseases [C10]
Gender: Female, Male. Age: 18-64 years, 65+ years. Enrolment: 83.
Status: Authorised, recruitment pending. Decision date: 2025-11-04. Results received: No. Last updated: 2025-11-05.
Decision dates by country: DK: 2025-11-04, NO: 2025-11-05

Condition(s): episodic cluster headache
Product: Placebo matching active ingredient. Encapsulated tablets., CANDESARTAN

Primary endpoint: Change in the weekly frequency of severe and very severe cluster headache attacks from the pre-randomization diary during the three-week blinded phase
Endpoint(s): Change from baseline in total attack frequency of cluster headache attacks during the three-week blinded phase, 50% responder rate (proportion of participants with ≥50% reduction of severe and very severe attacks/week from baseline) over the blinded phase, 30% responder rate (proportion of participants with ≥30% reduction of severe and very severe attacks/week from baseline) over the blinded phase, 50% responder rate for each week in the blinded phase, Time to sustained freedom of attacks for ≥2 months after the current bout, Change from baseline in mean intensity of severe and very severe attacks over the blinded period, Change from baseline in weekly number of acute pharmacological therapies over the blinded period, Change from baseline in weekly number of inhaled oxygen treatments over the blinded period, Percentage of patients who rated their improvement as 'very much better' (score of 1) or 'much better' (score of 2) on the Patient Global Impression of Improvement (PGI-I) scale at week 3, 9 and 14 after baseline., Percentage of patients who showed an improvement of more than 1 point on the HADS Anxiety (HADS-A) and/or Depression (HADS-D) subscales at weeks 3, 9, and 14 after baseline, Assessment and evaluation of participants for suicide-related events (behavior and/or ideation) as measured by the Columbia Suicide Severity Rating Scale (C-SSRS), Percentage of patients who reported a reduction of CH-specific disability at weeks 3, 9, and 14 after baseline as measured by the Cluster Headache Impact Questionnaire (CHIQ), Change in the weekly frequency of severe/very severe cluster headache attacks during the OTP compared with the weekly frequency in the blinded phase, Time to recurrence of severe/very severe attacks in participants during OTP who were attack-free at the end of the blinded phase, Proportion of participants achieving ≥50% reduction in use of weekly acute treatments in OTP compared with baseline, Time to recurrence of severe/very severe attacks in the wash-out phase in participants taking candesartan in the OTP, Proportion of participants who rate their overall condition as “much improved” or “very much improved” on PGIC at Week 8 of OTP, referenced to their status at the end of the BTP

Source: https://euclinicaltrials.eu/ctis-public/view/2025-521470-34-00